EU clinical trial 2024-515434-32-00: TROPHAMET, a phase I/II trial of Avelumab and METhotrexate in low-risk gestational TROPHoblastic neoplasias as first line treatment
Protocol code: 69HCL18 0857
Sponsor: Hospices Civils De Lyon (Hospital/Clinic/Other health care facility). Phase: Phase I and Phase II (Integrated)- Other. Countries: France (ongoing, recruitment ended).
Therapeutic area(s): Diseases [C] - Female Urogenital Diseases and Pregnancy Complications [C13]
Gender: Female. Age: 18-64 years. Enrolment: 26.
Status: Ongoing, recruitment ended. Start date (EU): 2020-02-12. Decision date: 2024-08-06. Results received: No. Last updated: 2025-10-09.

Condition(s): Low-risk gestational trophoblastic neoplasia

Source: https://euclinicaltrials.eu/ctis-public/view/2024-515434-32-00